EU clinical trial 2024-517814-13-00: A Phase 2b, Multicenter, Randomized, Double-blind, Placebo- and Active-controlled, Dose ranging Study to Evaluate the Efficacy and Safety of JNJ-95475939 for the Treatment of Participants with Moderate to Severe Atopic Dermatitis
Protocol code: 95475939ADM2001
Sponsor: Janssen Cilag International (Pharmaceutical company). Phase: Therapeutic exploratory (Phase II). Countries: Spain (ended), Poland (ended), Germany (ended).
Therapeutic area(s): Diseases [C] - Immune System Diseases [C20]
Gender: Female, Male. Age: 18-64 years, 65+ years. Enrolment: 86.
Status: Ended. Start date (EU): 2025-04-30. End date (EU): 2026-03-26. End date: 2026-03-27. Decision date: 2025-04-25. Results received: No. Last updated: 2025-12-29.
Decision dates by country: DE: 2025-04-28, PL: 2025-04-29, ES: 2025-04-25

Condition(s): Moderate to Severe Atopic Dermatitis
Product: JNJ-95475939, Placebo JNJ-95475939, Dupixent 300 mg solution for injection in pre-filled syringe

Primary endpoint: EASI 75 at Week 12

Source: https://euclinicaltrials.eu/ctis-public/view/2024-517814-13-00